EU clinical trial 2022-502444-13-00: A Multi-Center Study to Characterize the Long-Term Safety and Efficacy of BMS-986165 in Subjects with Systemic Lupus Erythematosus
Protocol code: IM011074
Sponsor: Bristol Myers Squibb International Corporation (Pharmaceutical company). Phase: Therapeutic exploratory (Phase II). Countries: Romania (ended), Hungary (ended), Spain (ended), Poland (ended).
Therapeutic area(s): Diseases [C] - Skin and Connective Tissue Diseases [C17]
Gender: Female, Male. Age: 18-64 years, 65+ years. Enrolment: 63.
Status: Ended. Start date (EU): 2019-05-28. End date (EU): 2025-03-10. End date: 2025-03-21. Decision date: 2023-10-16. Results received: Yes. Last updated: 2024-12-23.
Decision dates by country: HU: 2023-10-19, RO: 2023-10-17, ES: 2023-10-16, PL: 2023-12-07

Condition(s): Systemic Lupus Erythematosus
Product: Placebo to match deucravacitinib tablet, deucravacitinib 3 mg tablet, deucravacitinib 6 mg tablet, deucravacitinib 12 mg tablet

Primary endpoint: Adverse events and serious adverse events, vital sign measurements, and laboratory parameters
Endpoint(s): Efficacy: CLASI response, 40-joint count for tender, swollen, and tender + swollen joints, SRI(4) response, BICLA response, PGA, Corticosteroid use (yes/no), Corticosteroid dose ≤7.5 mg/day (yes/no), Flare Analysis o Time to first flare o Number and frequency of flares o Flares leading to hospitalization, SDI total score, BILAG response, SLEDAI-2K score, LLDAS response, PROMIS Fatigue Short Form 7a score, Pharmacokinetic: - Plasma concentrations of BMS-986165, Pharmacodynamic: - dsDNA, CRP, Complement levels, UPCR

Source: https://euclinicaltrials.eu/ctis-public/view/2022-502444-13-00